EU clinical trial 2024-513142-11-00: Phase Ib Randomised, Placebo-controlled, Double-blind, Multicentre Study to Assess the Effects and Safety of AZD5462 on top of Dapagliflozin in Participants with Heart Failure and Moderate Renal Impairment
Protocol code: D9090C00007
Sponsor: AstraZeneca AB (Pharmaceutical company). Phase: Human Pharmacology (Phase I)- Other. Countries: Bulgaria (ended), Sweden (ended).
Therapeutic area(s): Diseases [C] - Cardiovascular Diseases [C14]
Gender: Female, Male. Age: 18-64 years, 65+ years. Enrolment: 56.
Status: Ended. Start date (EU): 2024-09-27. End date (EU): 2025-05-29. Decision date: 2024-09-10. Results received: No. Last updated: 2025-04-09.
Decision dates by country: SE: 2024-09-10, BG: 2024-09-16

Condition(s): Moderate Renal Impairment, Heart Failure

Source: https://euclinicaltrials.eu/ctis-public/view/2024-513142-11-00